EU clinical trial 2025-521511-40-00: A Randomized Phase 2/3 Study of Navlimetostat (BMS-986504) in Combination with Pembrolizumab and Chemotherapy Versus Placebo Plus Pembrolizumab and Chemotherapy in First-line Metastatic Non-small Cell Lung Cancer Participants with Homozygous MTAP Deletion.
Protocol code: CA240-0029
Sponsor: Bristol-Myers Squibb Services Unlimited Company (Pharmaceutical company). Phase: Phase II and Phase III (Integrated). Countries: Greece (authorised, recruitment pending), Czechia (authorised, recruiting), France (ongoing, recruiting), Sweden (authorised, recruiting), Romania (ongoing, recruiting), Belgium (ongoing, recruiting), Austria (ongoing, recruiting), Bulgaria (ongoing, recruiting), Italy (ongoing, recruiting), Netherlands (ongoing, recruiting), Denmark (authorised, recruitment pending), Germany (ongoing, recruiting), Poland (authorised, recruiting), Hungary (authorised, recruiting), Spain (ongoing, recruiting).
Therapeutic area(s): Diseases [C] - Neoplasms [C04]
Gender: Female, Male. Age: 18-64 years, 65+ years. Enrolment: 195.
Start date (EU): 2025-11-18. Decision date: 2025-10-24. Results received: No. Last updated: 2026-08-06.
Decision dates by country: HU: 2025-11-10, BG: 2025-11-07, AT: 2025-10-27, NL: 2025-10-31, DK: 2025-10-31, SE: 2025-11-12, BE: 2025-10-30, RO: 2025-10-27, DE: 2025-10-24, PL: 2025-11-07, GR: 2025-11-12, IT: 2025-11-12, FR: 2025-11-03, CZ: 2025-11-03, ES: 2025-10-29

Condition(s): metastatic non-small cell lung cancer
Product: PEMETREXED, PEMBROLIZUMAB, Navlimetostat, PACLITAXEL ALBUMIN-BOUND, PACLITAXEL, CARBOPLATIN, MRTX1719 Matching Placebo, CISPLATIN

Primary endpoint: Phase 2: Progression free survival (PFS) by RECIST v1.1, Phase 3: Progression free survival (PFS) by RECIST v1.1, Phase 3: overall survival (OS).
Endpoint(s): Phase 2: objective response (OR), disease control (DC), time to objective response (TTOR), and duration of response (DOR)by RECIST v1.1, Phase 3: objective response (OR), disease control (DC), time to objective response (TTOR), duration of response (DOR), progression free survival (PFS) and PFS2 by RECIST v1.1, Phase 2: Treatment-related and all-cause adverse events (AEs), serious AEs (including fatal AEs); AEs leading to dose interruption, dose reduction, and study treatment discontinuation and laboratory abnormalities

Source: https://euclinicaltrials.eu/ctis-public/view/2025-521511-40-00